EU clinical trial 2024-511204-16-00: A Phase 3, multicenter, randomized, open-label, active-controlled study of trastuzumab deruxtecan (DS-8201a), an anti-HER2-antibody drug conjugate, versus ado-trastuzumab emtansine (T-DM1) for HER2-positive, unresectable and/or metastatic breast cancer subjects previously treated with trastuzumab and taxane (DESTINY-Breast03)
Protocol code: DS8201-A-U302
Sponsor: Daiichi Sankyo Inc. (Pharmaceutical company). Phase: Therapeutic confirmatory (Phase III). Countries: Belgium (ended), France (ended), Italy (ended), Spain (ended).
Therapeutic area(s): Diseases [C] - Neoplasms [C04]
Gender: Female, Male. Age: 18-64 years, 65+ years. Enrolment: 63.
Status: Ended. Start date (EU): 2019-01-23. End date (EU): 2026-07-28. Decision date: 2024-05-23. Results received: No. Last updated: 2026-08-05.
Decision dates by country: BE: 2024-05-24, ES: 2024-05-23, FR: 2024-05-24, IT: 2024-05-28

Condition(s): Metastatic breast cancer
Product: DS-8201a, Kadcyla 100 mg powder for concentrate for solution for infusion.

Primary endpoint: The primary efficacy endpoint is PFS as determined by blinded independent central review (BICR).
Endpoint(s): The key secondary efficacy endpoint is OS.

Source: https://euclinicaltrials.eu/ctis-public/view/2024-511204-16-00